EU clinical trial 2025-522695-83-00: A randomized, double-blind, placebo-controlled, Phase 2, dose-finding study to investigate the efficacy and safety of SAR445399 in participants with moderate to severe hidradenitis suppurativa
Protocol code: DRI20674
Sponsor: Sanofi-Aventis Recherche & Developpement (Pharmaceutical company). Phase: Therapeutic exploratory (Phase II). Countries: Hungary (ongoing, recruiting), Spain (ongoing, recruiting), France (ongoing, recruiting), Belgium (authorised, recruitment pending), Sweden (authorised, recruitment pending), Germany (ongoing, recruiting), Italy (ongoing, recruiting).
Therapeutic area(s): Diseases [C] - Immune System Diseases [C20]
Gender: Female, Male. Age: 18-64 years, 65+ years. Enrolment: 74.
Start date (EU): 2026-04-07. Decision date: 2026-03-02. Results received: No. Last updated: 2026-07-10.
Decision dates by country: HU: 2026-03-06, DE: 2026-03-04, IT: 2026-03-03, BE: 2026-03-02, FR: 2026-03-03, ES: 2026-03-04, SE: 2026-03-02

Condition(s): Hidradenitis suppurativa
Product: SAR445399, PB0867488 8mL solution for injection

Primary endpoint: Percentage of participants achieving Hidradenitis Suppurativa Clinical Response 75 (HiSCR75)
Endpoint(s): Percentage of participants achieving Hidradenitis Suppurativa Clinical Response 50 (HiSCR50), Absolute change from baseline to Week 16 in International Hidradenitis Suppurativa Severity Score System (IHS4), Percentage of participants achieving Achievement of Hidradenitis Suppurativa Clinical Response 90 (HiSCR90), Percent change from baseline to Week 16 in draining tunnel count, Absolute change from baseline to Week 16 in draining tunnel count, Percentage of participants with improvement from baseline to Week 16 of >=3 points in weekly average Hidradenitis Suppurativa Skin Pain Numeric Rating Scale (HS-Skin Pain NRS) item 1a from HS-SAQ, among participants with baseline HS-Skin Pain NRS ≥3, Percent change from baseline to Week 16 in Hidradenitis Suppurativa Skin Pain Numeric Rating Scale (HS-Skin Pain NRS), Absolute change from baseline to Week 16 in the Dermatology Life Quality Index (DLQI) total score, Absolute change from baseline to Week 16 in the total Hidradenitis Suppurativa Quality of Life (HiSQoL) score, Change from baseline to Week 16 in Weekly average HS-SAQ score items, Change from baseline to Week 16 in the Hidradenitis Suppurativa Impact Assessment Questionnaire (HS-IAQ) total score, Improvement in Peak Pruritus Numerical Rating Scale (PP-NRS) at Week 16, Number of participants with Treatment Emergent Adverse Events (TEAEs) Adverse Events of Special Interest (AESIs), and Serious Adverse Events (SAEs) including site reactions during the double-blinded initial treatment period and the treatment-blinded extensio period, Number of participants with potentially clinically significant abnormalities in laboratory tests, vital signs, and electrocardiograms (ECGs) during the double-blinded initial treatment period and the treatment-blinded extension period, Plasma concentrations of SAR445399 during the double-blinded initial treatment period and the treatment-blinded extension period, Incidence of anti drug antibodies (ADA) of SAR445399 at prespecified timepoints during the double-blinded initial treatment period and the treatment-blinded extension period

Source: https://euclinicaltrials.eu/ctis-public/view/2025-522695-83-00